EU clinical trial 2023-505097-16-00: OPAL Master Protocol: A Phase 1B/2 Multicohort Umbrella Study to Evaluate the Safety and Efficacy of Novel Treatments and/or Combinations of Treatments in Participants with Ovarian Cancer (OPAL) (PR-3000-02-005/213357) Cohort C: Open-label Phase 2, Randomized, Controlled Multicenter Study Comparing Niraparib Versus Platinum-Taxane Doublet Chemotherapy as Neoadjuvant Treatment in Participants with Homologous Recombination- Deficient Stage III/IV Ovarian Cancer
Protocol code: 213357
Sponsor: Tesaro Inc. (Pharmaceutical company). Phase: Therapeutic exploratory (Phase II). Countries: Spain (ended).
Therapeutic area(s): Diseases [C] - Neoplasms [C04]
Gender: Female. Age: 18-64 years, 65+ years. Enrolment: 15.
Status: Ended. Start date (EU): 2022-04-04. End date (EU): 2025-03-31. End date: 2025-04-01. Decision date: 2024-02-07. Results received: Yes. Last updated: 2025-01-14.

Condition(s): Ovarian Neoplasms
Product: Carboplatin 10 mg/ml Concentrate for Solution for Infusion, Avastin 25 mg/ml concentrate for solution for infusion., Paclitaxel 6 mg/ml Concentrate for Solution for Infusion, Zejula 100 mg hard capsules, Zejula 100 mg hard capsules, Zejula 100 mg hard capsules, Avastin 25 mg/ml concentrate for solution for infusion.

Primary endpoint: The primary efficacy endpoint for this cohort is pre-IDS unconfirmed ORR, defined as the percentage of participants with unconfirmed CR or PR on study treatment pre-IDS as assessed per RECIST v1.1 by the Investigator.
Endpoint(s): Incidence of CA-125 progression per GCIG CA-125 response criteria, PFS, defined as the time from the date of treatment randomization to the date of first documentation of PD per RECIST v1.1 or death by any cause, whichever occurs first, as determined by the Investigator, OS, defined as the time from the date of treatment randomization to the date of death by any cause, TFST, defined as the time from the date of treatment randomization to the date of first subsequent anticancer therapy or death, Safety endpoints include frequency and severity of treatment-emergent adverse events, serious adverse events, AESIs, and dose modification (i.e., interruptions and discontinuations)., Change over time in frequency and severity of the items on the Patient Reported Outcomes-Common Terminology Criteria for Adverse Events during neoadjuvant treatment, Change from baseline in Functional Assessment of Cancer Therapy-Item GP5 during neoadjuvant treatment, Change from baseline in European Organisation for Research and Treatment of Cancer (EORTC) Quality of Life Questionnaire-Core 30 items (EORTC Item Library 136) pre-IDS, Change from baseline in EORTC Quality of Life Questionnaire for OC gastrointestinal items (EORTC Item Library 137) pre-IDS

Source: https://euclinicaltrials.eu/ctis-public/view/2023-505097-16-00